EU clinical trial 2025-522325-35-00: A study in healthy people to compare how 2 different formulations of survodutide are taken up by the body
Protocol code: 1404-0103
Sponsor: Boehringer Ingelheim International GmbH (Pharmaceutical company). Phase: Human Pharmacology (Phase I)- Other. Countries: Germany (ended).
Therapeutic area(s): Not possible to specify
Gender: Female, Male. Age: 18-64 years, 65+ years. Enrolment: 100.
Status: Ended. Start date (EU): 2025-10-27. End date (EU): 2026-07-28. Decision date: 2025-09-02. Results received: No. Last updated: 2026-02-11.

Condition(s): Healthy volunteer trial

Source: https://euclinicaltrials.eu/ctis-public/view/2025-522325-35-00